EU clinical trial 2024-511493-67-00: A first-in-human, phase I, single-center, open-label, dose-escalation trial in healthy volunteers to assess safety, tolerability, and immunogenicity of PANHPVAX, a vaccine targeting human papilloma L2 antigen formulated with cyclic di-AMP
Sponsor: Deutsches Krebsforschungszentrum Stiftung Des Oeffentlichen Rechts (Laboratory/Research/Testing facility). Phase: Human Pharmacology (Phase I)- First administration to humans. Countries: Germany (ongoing, recruiting).
Therapeutic area(s): Diseases [C] - Virus Diseases [C02]
Gender: Female, Male. Age: 18-64 years. Enrolment: 45.
Status: Ongoing, recruiting. Start date (EU): 2022-10-07. Decision date: 2024-06-06. Results received: No. Last updated: 2025-04-28.

Condition(s): Prophylactic vaccination against HPV in healthy volunteers

Source: https://euclinicaltrials.eu/ctis-public/view/2024-511493-67-00